EU clinical trial 2023-507737-17-00: A randomized double-blind placebo-controlled first-in-man single-dose and multiple dose study to evaluate the safety, tolerability and efficacy of a recombinant chimeric bacteriophage endolysin HY-133 with an extended phase to evaluate effects of the nasal microbiome
Protocol code: HY-133
Sponsor: Universitaetsklinikum Tuebingen AöR (Hospital/Clinic/Other health care facility). Phase: Human Pharmacology (Phase I)- First administration to humans. Countries: Germany (ongoing, recruiting).
Therapeutic area(s): Diseases [C] - Bacterial Infections and Mycoses [C01]
Gender: Female, Male. Age: 18-64 years, 65+ years. Enrolment: 52.
Status: Ongoing, recruiting. Start date (EU): 2024-07-10. Decision date: 2024-03-28. Results received: No. Last updated: 2025-12-03.

Condition(s): Nasal colonization with methicillin-susceptible Staphylococcus aureus (MSSA)

Source: https://euclinicaltrials.eu/ctis-public/view/2023-507737-17-00